EU clinical trial 2024-511948-42-00: Evaluation of clinical impact of the type of cardioplegia used in the patient undergoing major cardiac surgery with extracorporeal circulation. CARDIO-HEART clinical trial.
Protocol code: CARDIO-HEART
Sponsor: Hospital Clinico San Carlos (Hospital/Clinic/Other health care facility). Phase: Therapeutic use (Phase IV). Countries: Spain (authorised, recruitment pending).
Therapeutic area(s): Diseases [C] - Cardiovascular Diseases [C14]
Gender: Female, Male. Age: 18-64 years, 65+ years. Enrolment: 600.
Status: Authorised, recruitment pending. Decision date: 2024-06-03. Results received: No. Last updated: 2024-06-03.

Condition(s): Cardiovascular surgery
Product: Cardi-Braun Mantenimiento solución para perfusión, CUSTODIOL® - Perfusionslösung

Primary endpoint: a) Comparison of the composite event of death, perioperative AMI, low cardiac postoperative output with need for ionotropics, and AKIN-III acute kidney failure in patients administered Custodiol crystalloid cardioplegia and Buckberg hematic cardioplegia 90 days after the intervention.
Endpoint(s): a) Comparison of the elevation of Troponin I US at 12 and 24 hours after the procedure., b) Comparison of 90-day postoperative mortality., c) Comparison of low cardiac postoperative output event with need for ionotropic drugs in the first 24 hours., d) Comparison of AKIN-III acute kidney failure event., e) Comparison of perioperative AMI incidence., f) Comparison of major bleeding event or life-threatening or disabling hemorrhage., g) Comparison of the need for transfusion of blood products (absolute number) in the first 48 hours., h) Comparison of the need for prolonged mechanical ventilation for >24h., i) Comparison of type 1 and type 2 neurological complications., j) Comparison of the incidence of postoperative atrial fibrillation., k) Comparison of overall survival at 90 days.

Source: https://euclinicaltrials.eu/ctis-public/view/2024-511948-42-00